EU clinical trial 2024-519235-42-00: Effects of GLP-1 analogue in multiple sclerosis
Protocol code: MSGLP/GAMS
Sponsor: Comenius University Bratislava (Educational Institution). Phase: Therapeutic exploratory (Phase II). Countries: Slovakia (authorised, recruitment pending).
Therapeutic area(s): Diseases [C] - Nervous System Diseases [C10]
Gender: Female, Male. Age: 18-64 years. Enrolment: 1.
Status: Authorised, recruitment pending. Decision date: 2024-11-07. Results received: No. Last updated: 2024-11-07.

Condition(s): Patients with confirmed multiple sclerosis (MS), with worse prognosis given the higher disease activity, in productive age between 18 and 60 years, with EDSS<5, who at the time of investigation are on baseline therapy of the disease for at least 3 months
Product: Rybelsus 3 mg tablets, Trulicity 0.75 mg solution for injection in pre-filled pen, Rybelsus 7 mg tablets, Rybelsus 14 mg tablets

Primary endpoint: Annualized change in brain volume and gray matter volume. Serum neurofilament L level.
Endpoint(s): Secondary end points: Insulin sensitivity through ISI Cederholm, ISI Matsuda, HOMA-IR and HOMA-IR2. Scores in Symbol Digit Modalities Test (SDMT) and Stroop Test.

Source: https://euclinicaltrials.eu/ctis-public/view/2024-519235-42-00